EU clinical trial 2024-510576-21-00: Personalized dosing of FOLFIRINOX in pancreatic cancer patients: a phase-2 pharmacokinetic, safety and feasibility trial
Protocol code: PERFUPANC-001
Sponsor: Catharina Ziekenhuis Stichting (Hospital/Clinic/Other health care facility). Phase: Therapeutic exploratory (Phase II). Countries: Netherlands (ongoing, recruiting).
Therapeutic area(s): Diseases [C] - Digestive System Diseases [C06]; Analytical, Diagnostic and Therapeutic Techniques and Equipment [E] - Therapeutics [E02]; Diseases [C] - Neoplasms [C04]
Gender: Female, Male. Age: 18-64 years, 65+ years. Enrolment: 100.
Status: Ongoing, recruiting. Start date (EU): 2024-09-18. Decision date: 2024-07-09. Results received: No. Last updated: 2024-07-09.

Condition(s): Pancreatic cancer
Product: Irinotecan HCl-trihydraat Fresenius Kabi 20 mg/ml, concentraat voor oplossing voor infusie, Folikabi 10 mg/ml oplossing voor injectie/infusie, Oxaliplatine Accord 5 mg/ml concentraat voor oplossing voor infusie, Fluorouracil Accord 50 mg/ml, oplossing voor injectie of infusie

Primary endpoint: Percentage of patients undergoing FOLFIRINOX treated with standard-dosed (BSA) 5-FU achieving a 5-FU target AUC range (5-FU AUC0-46h between 20 and 30 mg*h/L) within two dose cycles of 5-FU, Percentage of patients undergoing FOLFIRINOX treated with 5-FU MIPD achieving a 5-FU target AUC range (5-FU AUC0-46h between 20 and 30 mg*h/L) within two dose cycles of 5-FU
Endpoint(s): Incidence of grade ≥ 1-5 toxicity, toxicity-related hospitalization, treatment delay (> 2 days) and early treatment withdrawal in patients treated with FOLFIRINOX, Turn-around-time of 5-FU MIPD (or incidence of treatment delay due to 5-FU MIPD), Compliance to 5-FU MIPD dosing advice by treating physicians, Pharmacokinetics of 5-FU, FUH2, Irinotecan, SN-38, SN38G and Oxaliplatin, Direct medical costs of 5-FU based treatment, Disease free surivival, progression free survival, objective response rate and overall survival of patients treated with FOLFIRINOX, AUC0-46h of 5-FU in patients treated with FOLFIRINOX, Correlation of patient and treatment characteristics with AUC of 5-FU and/or irinotecan and their metabolites

Source: https://euclinicaltrials.eu/ctis-public/view/2024-510576-21-00